EU clinical trial 2023-508849-40-00: The efficacy of aprepitant for the prevention of postoperative nausea and vomiting after bariatric surgery.
Protocol code: PONVApr1
Sponsor: University Of Tartu (Educational Institution). Phase: Therapeutic use (Phase IV). Countries: Estonia (ongoing, recruitment ended).
Therapeutic area(s): Diseases [C] - Digestive System Diseases [C06]
Gender: Female, Male. Age: 18-64 years, 65+ years. Enrolment: 260.
Status: Ongoing, recruitment ended. Start date (EU): 2024-04-11. Decision date: 2024-04-02. Results received: No. Last updated: 2025-01-07.

Condition(s): Postoperative nausea and vomiting
Product: Aprepitant Sandoz, 125 mg, kõvakapslid + Aprepitant Sandoz, 80 mg, kõvakapslid, Platseebo 80mg kõvakapsel Läbipaistmatu, želatiinist kõvakapsel suurusega 2, valge kapslikeha ja valge kapslikaanega, sisaldab glükoosi Placebo will be produced by East Tallinn-Central Hospital Pharmacy.

Primary endpoint: Incidence of PONV, Severity of PONV measured by NRS (numeric rate scale) and Rhodes scale, Use of rescue medication, type and dose.
Endpoint(s): Correlation between intraabdominal pressure during surgery and PONV incidence and severity., Length of stay in recovery room, Length of hospital stay, Subjective patient satisfaction assessment NRS (1-10) of postoperative period.

Source: https://euclinicaltrials.eu/ctis-public/view/2023-508849-40-00